EU clinical trial 2024-515669-32-00: A Phase 3, Prospective, Multicenter, Double-blind, Double-dummy, Randomized, Active-controlled, Parallel-group, Group-sequential, Adaptive, Event-driven Study to Compare Efficacy, Safety, and Tolerability of Macitentan 75 mg Versus Macitentan 10 mg in Patients with Pulmonary Arterial Hypertension, Followed by an Open-label Treatment Period With Macitentan 75 mg
Protocol code: AC-055-315
Sponsor: Actelion Pharmaceuticals Ltd. (Pharmaceutical company). Phase: Therapeutic confirmatory (Phase III). Countries: Austria (ongoing, recruitment ended), Poland (ongoing, recruitment ended), Belgium (ended), Greece (ongoing, recruitment ended), Spain (ongoing, recruitment ended), France (ongoing, recruitment ended), Germany (ongoing, recruitment ended), Hungary (ongoing, recruitment ended), Bulgaria (ongoing, recruitment ended), Portugal (ongoing, recruitment ended), Slovakia (ongoing, recruitment ended), Italy (ongoing, recruitment ended), Czechia (ongoing, recruitment ended), Denmark (ongoing, recruitment ended), Sweden (ongoing, recruitment ended), Netherlands (ongoing, recruitment ended).
Therapeutic area(s): Diseases [C] - Cardiovascular Diseases [C14]
Gender: Female, Male. Age: 18-64 years, 65+ years. Enrolment: 110.
Start date (EU): 2020-06-30. Decision date: 2024-07-30. Results received: No. Last updated: 2026-06-24.
Decision dates by country: BE: 2024-07-31, FR: 2024-08-01, PL: 2024-08-04, DK: 2024-07-31, CZ: 2024-08-02, BG: 2024-08-05, AT: 2024-09-08, GR: 2024-09-16, SE: 2024-07-31, PT: 2024-09-10, IT: 2024-08-12, ES: 2024-08-01, HU: 2024-08-01, NL: 2024-07-30, SK: 2024-08-01, DE: 2024-08-05

Condition(s): Pulmonary arterial hypertension
Product: Opsumit 10 mg film-coated tablets, Matching Placebo for Macitentan 37.5 mg, JNJ 67896062, Matching Placebo for Macitentan 75 mg, Matching Placebo for Macitentan 10 mg, JNJ 67896062

Primary endpoint: Time to first CEC-adjudicated M/M event on-treatment (ie, up to 7 days after the last dose of double-blind (DB) study intervention)

Source: https://euclinicaltrials.eu/ctis-public/view/2024-515669-32-00